EU clinical trial 2023-510263-35-00: A study in healthy men to test whether zongertinib influences the amount of 3 other medicines in the blood
Protocol code: 1479-0014
Sponsor: Boehringer Ingelheim International GmbH (Pharmaceutical company). Phase: Human Pharmacology (Phase I)- Other. Countries: Germany (ended).
Therapeutic area(s): Not possible to specify
Gender: Male. Age: 18-64 years. Enrolment: 16.
Status: Ended. Start date (EU): 2024-07-22. End date (EU): 2024-10-16. Decision date: 2024-05-29. Results received: No. Last updated: 2024-07-11.

Condition(s): Pharmacokinetic trial

Source: https://euclinicaltrials.eu/ctis-public/view/2023-510263-35-00